EU clinical trial 2025-525016-41-00: A Phase IIb Study to Evaluate the Efficacy, Safety, and Tolerability of AZD8965 in Participants with Idiopathic Pulmonary Fibrosis (IPF)) (ARGiNAUT)
Protocol code: D6960C00005 ARGiNAUT
Sponsor: AstraZeneca AB (Pharmaceutical company). Phase: Therapeutic exploratory (Phase II). Countries: Germany (authorised, recruitment pending), Spain (authorised, recruitment pending), Greece (authorised, recruitment pending), Bulgaria (authorised, recruitment pending), Italy (authorised, recruitment pending), France (authorised, recruitment pending).
Therapeutic area(s): Diseases [C] - Respiratory Tract Diseases [C08]
Gender: Female, Male. Age: 18-64 years, 65+ years. Enrolment: 100.
Status: Authorised, recruitment pending. Decision date: 2026-08-04. Results received: No. Last updated: 2026-08-07.
Decision dates by country: BG: 2026-08-07, FR: 2026-08-06, DE: 2026-08-04, GR: 2026-08-06, IT: 2026-08-07, ES: 2026-08-07

Condition(s): Idiopathic Pulmonary Fibrosis
Product: AZD8965, Placebo to AZD8965, AZD8965

Primary endpoint: Change from baseline in FVC (mL)
Endpoint(s): 1. Change from baseline in FVC (mL), 2. Change from baseline in % predicted FVC, 3. Slope (rate of decline) in FVC (mL/week), 4. AEs, DAEs, SAEs, AESIs, vital signs, clinical laboratory assessments (eg, clinical chemistry, hematology, urinalysis), ECGs, 5. AZD8965 plasma concentrations

Source: https://euclinicaltrials.eu/ctis-public/view/2025-525016-41-00